EU clinical trial 2024-513595-17-00: Efficacy and tolerability of ODM-111 in chronic pain due to diabetic peripheral neuropathy
Protocol code: 3133004
Sponsor: Orion Corporation (Pharmaceutical company). Phase: Therapeutic exploratory (Phase II). Countries: Germany (ended), Czechia (ended), Bulgaria (ended), Poland (ended), Hungary (ended).
Therapeutic area(s): Diseases [C] - Nervous System Diseases [C10]
Gender: Female, Male. Age: 18-64 years, 65+ years. Enrolment: 203.
Status: Ended. End date (EU): 2024-10-28. Decision date: 2024-10-21. Results received: Yes. Last updated: 2024-10-28.
Decision dates by country: BG: 2024-10-21, CZ: 2024-10-23, DE: 2024-10-21, HU: 2024-10-22, PL: 2024-10-28

Condition(s): CHRONIC PAIN DUE TO DIABETIC PERIPHERAL NEUROPATHY
Product: Para-Tabs 500 mg tabletti, ODM-111 Placebo, ODM-111, ODM-111

Primary endpoint: The primary efficacy endpoint is the change from baseline to week 6 in the weekly average of daily pain intensity (average over the previous 24 hours) on the 11-point numeric rating scale (NRS), as reported in the daily eDiary.

Source: https://euclinicaltrials.eu/ctis-public/view/2024-513595-17-00